EU clinical trial 2024-516660-28-01: A Phase I Interventional Open-Label, Non-Randomized Dose-Escalation Trial to Evaluate the Safety, Tolerability, Pharmacokinetics, Pharmacodynamics, Immunogenicity, and Preliminary Anti-Tumor Activity of Autologous p95HER2.CAR-TECH2Me T Cells in Patients with Selected Advanced Cancers. Catherine Trial
Protocol code: VHIO24001
Sponsor: Vall D Hebron Institute Of Oncology (Laboratory/Research/Testing facility). Phase: Human Pharmacology (Phase I)- First administration to humans. Countries: Spain (ongoing, recruiting).
Therapeutic area(s): Diseases [C] - Neoplasms [C04]
Gender: Female, Male. Age: 18-64 years, 65+ years. Enrolment: 15.
Status: Ongoing, recruiting. Start date (EU): 2026-04-17. Decision date: 2025-12-17. Results received: No. Last updated: 2025-12-17.

Condition(s): Locally advanced, recurrent, or metastatic breast, gastric, endometrial, and selected other solid tumors with positive expression for HER-2 (3+)

Source: https://euclinicaltrials.eu/ctis-public/view/2024-516660-28-01